EU clinical trial 2024-519578-38-00: A Phase 2/3 Study to Evaluate the Safety, Efficacy, and Pharmacokinetics of Atumelnant Treatment in Pediatric Participants with Congenital Adrenal Hyperplasia Including a Long-Term Extension
Protocol code: CRN04894-13
Sponsor: Crinetics Pharmaceuticals Inc. (Pharmaceutical company). Phase: Phase II and Phase III (Integrated). Countries: Italy (authorised, recruiting), Germany (authorised, recruiting), France (ongoing, recruiting), Belgium (ongoing, recruiting), Netherlands (authorised, recruiting), Poland (ongoing, recruiting).
Therapeutic area(s): Diseases [C] - Hormonal diseases [C19]; Diseases [C] - Congenital, Hereditary, and Neonatal Diseases and Abnormalities [C16]
Gender: Female, Male. Age: 0-17 years. Enrolment: 61.
Start date (EU): 2026-03-30. Decision date: 2025-12-09. Results received: No. Last updated: 2026-05-19.
Decision dates by country: NL: 2025-12-09, PL: 2025-12-14, IT: 2025-12-09, BE: 2025-12-10, DE: 2025-12-12, FR: 2025-12-15

Condition(s): Classic congenital adrenal hyperplasia
Product: Atumelnant 80 mg tablets, Atumelnant 40 mg tablet, Atumelnant 20 mg tablets, Tablet

Primary endpoint: Part A: -Incidence of TEAEs including treatment emergent SAEs and any Aes leading to discontinuation. -Change from baseline in morning A4 at Week 8 Part B: -Percent change from baseline in GC daily dose at Week 28 while serum early morning A4≤ULN Part C: -Change from baseline in morning A4 over time
Endpoint(s): Part A: -Change from baseline in morning serum 17-OHP at Week 8 -Plasma and blood concentrations of atumelnant, Part B: -Change from baseline in morning A4 at Week 4 -Change from baseline in morning 17 OHP at Week 4 -Proportion of participants with physiologic GC dose while morning A4 , Part C: -Change from baseline in morning 17-OHP over time -Percent change from baseline in GC daily dose over time -Proportion of participants with physiologic GC dose while morning A4

Source: https://euclinicaltrials.eu/ctis-public/view/2024-519578-38-00